EU clinical trial 2024-510571-37-00: A Phase I/II, observer-blind, randomised, placebo-controlled, multi-country study to evaluate reactogenicity, safety, immune response, and efficacy of an HSV-targeted immunotherapy in healthy participants aged 18-40 years or in participants aged 18-60 years with recurrent genital herpes.
Protocol code: 215336
Sponsor: GlaxoSmithKline Biologicals (Pharmaceutical company). Phase: Phase I and Phase II (Integrated)- First administration to humans. Countries: Estonia (ended), Belgium (ended), Spain (ended), Germany (ended).
Therapeutic area(s): Diseases [C] - Virus Diseases [C02]
Gender: Female, Male. Age: 18-64 years. Enrolment: 407.
Status: Ended. Start date (EU): 2023-12-06. End date (EU): 2025-04-10. End date: 2025-06-12. Decision date: 2024-05-15. Results received: Yes. Last updated: 2025-05-27.
Decision dates by country: ES: 2024-05-17, EE: 2024-05-20, BE: 2024-05-24, DE: 2024-05-15

Condition(s): Herpes Simplex
Product: NaCl solution

Primary endpoint: "• Percentage of participants reporting each solicited administration site event (redness, pain, and swelling) within 7 days (Day 1-Day 7) post-each dose. • Percentage of participants reporting each solicited systemic event (fever, fatigue, headache, myalgia, arthralgia) within 7 days (Day 1-Day 7) post-each dose. • Percentage of participants reporting unsolicited AEs within 28 days (Day 1-Day 28) post-each dose.", "• Percentage of participants reporting MAEs from Dose 1 (Day 1) up to 12 months after last study intervention administration (Day 394). • Percentage of participants reporting any SAEs from Dose 1 (Day 1) up to 12 months after last study intervention administration (Day 394). • Percentage of participants reporting any pIMDs (classified as newly diagnosed or exacerbation of pre-existing events) from Dose 1 (Day 1) up to 12 months after last study intervention administration (Day 394).", "• Only for PART I: Percentage of participants reporting any haematological and biochemical laboratory abnormalities post Dose 1 (Day 8 and Day 29), post-Dose 2 (Day 36 and Day 64). • Only for PART II: Percentage of participants reporting any haematological and biochemical laboratory abnormalities post Dose 1 (Day 8 and Day 29), post Dose 2 (Day 36 and Day 57). ", "• Time-to-first confirmed HSV-2 RGH episode."
Endpoint(s): •Number of confirmed HSV-2 RGH episodes divided by the number of days of follow-up assessed until end of RGH event reporting period •Percentage of participants free from confirmed HSV 2 RGH episode at 6months after the last dose of study intervention •HSC total score during each confirmed HSV-2 RGH episode assessed until end of RGH event reporting period •Number of days with RGH-associated symptoms during each confirmed HSV-2 RGH episode assessed until end of RGH event reporting period, • Number of days with confirmed HSV-2 genital herpes lesions divided by the number of days of follow-up assessed until end of RGH event reporting period. • HSV-2 shedding rate reduction (overall, asymptomatic and symptomatic) from baseline to about 6 weeks post Dose 2 (Day 71). • Number and duration of HSV-2 DNA shedding episodes during the 28-day periods starting at baseline (Day -28), Day 43, Day 181 (overall, asymptomatic and symptomatic)., • Only for PART I: Anti-gE-gI antibody GMC and seropositivity rate (assessed by ELISA) at pre study intervention administration (Day 1), post-Dose 1 (Day 29), post Dose 2 (Day 64), 6 months post Dose 2 (Day 209) and 12 months post-Dose 2 (Day 394). • Only for PART II: Anti-gE-gI antibody GMC and seropositivity rate (assessed by ELISA) at pre study intervention administration (Day 1), post-Dose 1 (Day 29), and 1 month post Dose 2 (Day 57)., • Only for PART I: Geometric mean of gE-gI-specific CD4+/CD8+ Tcells frequency expressing at least 2 activation markers (IFN-γ, TNF-α, IL-2, IL-13, IL17, 4-1BB and/or CD40L) and including at least one cytokine (assessed by CFC) at pre-study intervention administration (Day 1), postDose 1 (Day 29), postDose 2 (Day 64), 6 months postDose 2 (Day 209) and 12 months post-Dose 2 (Day 394)., • Only for PART II: Geometric mean of gE gI-specific CD4+/CD8+ T cells frequency expressing at least 2 activation markers (IFN-γ, TNF-α, IL-2, IL-13, IL 17, 4-1BB and/or CD40L) and including at least one cytokine (assessed by CFC) at pre-study intervention administration (Day 1), post Dose 1 (Day 29), and 1 month post-Dose 2 (Day 57).

Source: https://euclinicaltrials.eu/ctis-public/view/2024-510571-37-00